EU clinical trial 2024-511450-49-00: J1I-MC-GZBP: A Phase 3, Randomized, Double-Blind Study to Evaluate the Efficacy and Safety of Retatrutide Compared to Tirzepatide in Adults Who Have Obesity
Protocol code: J1I-MC-GZBP
Sponsor: Eli Lilly & Co. (Pharmaceutical company). Phase: Therapeutic confirmatory (Phase III). Countries: Poland (ongoing, recruitment ended), Germany (ongoing, recruitment ended).
Therapeutic area(s): Diseases [C] - Nutritional and Metabolic Diseases [C18]
Gender: Female, Male. Age: 18-64 years, 65+ years. Enrolment: 225.
Status: Ongoing, recruitment ended. Start date (EU): 2024-10-22. Decision date: 2024-09-20. Results received: No. Last updated: 2026-07-23.
Decision dates by country: PL: 2024-09-24, DE: 2024-09-20

Condition(s): Obesity
Product: Retatrutide, Tirzepatide, Tirzepatide, Retatrutide, Tirzepatide, Retatrutide, Tirzepatide, Tirzepatide, Tirzepatide, Retatrutide, Retatrutide

Primary endpoint: Percent Change from Baseline in Body Weight

Source: https://euclinicaltrials.eu/ctis-public/view/2024-511450-49-00